EU clinical trial 2023-506419-16-00: A Randomized, Open-label, Phase 3 Trial of A+AVD Versus ABVD as Frontline Therapy in Patients With Advanced Classical Hodgkin Lymphoma
Protocol code: C25003
Sponsor: Takeda Development Center Americas Inc. (Pharmaceutical company). Phase: Therapeutic confirmatory (Phase III). Countries: Denmark (ended), Hungary (ended), Italy (ended), Belgium (ended), Spain (ended), France (ended), Norway (ended), Poland (ended), Czechia (ended).
Therapeutic area(s): Diseases [C] - Neoplasms [C04]
Gender: Female, Male. Age: 18-64 years, 65+ years. Enrolment: 448.
Status: Ended. Start date (EU): 2013-01-08. End date (EU): 2026-02-02. End date: 2026-02-03. Decision date: 2024-02-06. Results received: No. Last updated: 2026-02-24.
Decision dates by country: BE: 2024-02-14, CZ: 2024-02-07, DK: 2024-02-06, FR: 2024-02-08, HU: 2024-02-06, NO: 2024-02-06, PL: 2024-02-08, IT: 2024-02-07, ES: 2024-02-07

Condition(s): Advanced Classical Hodgkin Lymphoma
Product: Doxorubicinhydrochlorid Teva® 2 mg/ml Konzentrat zur Herstellung einer Infusionslösung, Bleomycin 15000 IU Powder for solution for injection/infusion, Detimedac 200 mg, Pulver zur Herstellung einer Injektions-/Infusionslösung, Doxorubicin hydrochloride 2 mg/ml solution for infusion, ADCETRIS 50 mg powder for concentrate for solution for infusion, Vinblastine Sulfate 1 mg/ml solution for injection, Dacarbazine medac 200 mg, powder for solution for injection/infusion, Vinblastinsulfat Teva® 1 mg/ml Injektionslösung, Bleomedac®

Primary endpoint: Modified PFS per IRF assessment using the Revised Response Criteria for Malignant Lymphoma
Endpoint(s): Overall survival

Source: https://euclinicaltrials.eu/ctis-public/view/2023-506419-16-00